EU clinical trial 2023-506543-41-00: A Single Arm, Open Label Multicentre Extension Study to Evaluate the Effectiveness and Safety of Ocrelizumab in Patients with Multiple Sclerosis Previously Enrolled in A F. Hoffmann-La Roche Sponsored Ocrelizumab Phase IIIb/IV Clinical Trial
Protocol code: MN39158
Sponsor: F. Hoffmann-La Roche AG (Pharmaceutical company). Phase: Therapeutic confirmatory (Phase III). Countries: Hungary (ended), Norway (ended), Croatia (ended), Denmark (ended), Slovakia (ended), Belgium (ended), Netherlands (ended), Sweden (ended), Italy (ended), Portugal (ended), Slovenia (ended), France (ended), Poland (ended), Bulgaria (ended).
Therapeutic area(s): Diseases [C] - Nervous System Diseases [C10]
Gender: Female, Male. Age: 18-64 years. Enrolment: 645.
Status: Ended. Start date (EU): 2018-07-25. End date (EU): 2025-04-22. End date: 2025-07-17. Decision date: 2023-12-15. Results received: Yes. Last updated: 2025-06-16.
Decision dates by country: BE: 2023-12-18, HR: 2023-12-18, DK: 2023-12-18, FR: 2023-12-19, HU: 2023-12-15, IT: 2023-12-18, SE: 2023-12-15, NL: 2023-12-18, NO: 2023-12-15, SK: 2023-12-15, PT: 2023-12-15, BG: 2024-02-07, PL: 2024-01-10, SI: 2023-12-15

Condition(s): Multiple sclerosis (MS)
Product: Methylprednisolone 500 mg powder and solvent for solution for injection/infusion, Ocrevus 300 mg concentrate for solution for infusion, Paracetamol Accord 1000 mg comprimate efervescente, Ocrevus 300 mg concentrate for solution for infusion, Diphenhydramine Hydrochloride Tablets 50 mg

Primary endpoint: 1. Evaluate clinical measures related to disease progression over the duration of treatment in MS patients
Endpoint(s): 1. Related to disability progression: Time to onset of Confirmed disability progression (CDP) sustained for at least 24 weeks and for at least 48 weeks, 2. Related to disability progression: Proportion of patients who have confirmed disability improvement (CDI), CDP for at least 24 weeks and for at least 48 weeks yearly and over the duration of treatment, 3. Related to disability progression: Proportion of patients who have improved, stable or worsened disability compared with baseline (inclusion in the study) measured by expanded disability status scale (EDSS), 4. Related to disability progression: Mean change from inclusion in the parent study in EDSS score over the course of treatment, 5. Related to disability progression: Time to 20% increase in timed 25-foot walk test (T25FWT); time to 20% increase in timed nine-hole peg test (9HPT) sustained for at least 24 weeks and for at least 48 weeks, and proportion of patients achieving a sustained increase assessed yearly and over the duration of treatment, 6. Other clinical measures and composite endpoints: Time to first protocol-defined event of disease activity, 7. Other clinical measures and composite endpoints: Time to first relapse, 8. Other clinical measures and composite endpoints: Annualized relapse rate, 9. Other clinical measures and composite endpoints: Proportion of patient relapse free, yearly and over the course of treatment, 10. Other clinical measures and composite endpoints: Proportion of patients with no evidence of protocol-defined disease activity (NEDA) yearly and over the duration of the treatment, 11. Other clinical measures and composite endpoints: Proportion of patients with no evidence of progression, measured by EDSS, 9HPT and T25FW (if assessments are available), 12. Other clinical measures and composite endpoints: Proportion of patients with no evidence of progression sustained for at least 24 weeks and no active disease (if assessments are available), 13. Other clinical measures and composite endpoints: Change from baseline (parent trial) in cognitive performance as measured by the Symbol digit modalities test (SDMT), 14. Related to MRI: Total number of T1 Gd-enhancing lesions as detected by brain MRI over time, 15. Related to MRI: Total number of new and/or enlarging T2 lesion as detected by brain MRI over time, 16. Related to MRI: Change in total T1 hypointense lesion volume over time, 17. Related to MRI: Total number of fluid-attenuated inversion-recovery (FLAIR) late enhancing lesions as detected by brain MRI over time (pertinent to CASTING/MA30005 patients only), 18. Related to MRI: Total number of FLAIR late enhancing lesions as detected by brain MRI at the end of the treatment period, 19. Related to MRI: Change in brain volume (including white and grey matter fractions) as detected by brain MRI over time, 20. Related to MRI: Presence and evolution of leptomeningeal follicles (pertinent to ENSEMBLE/MA30143 patients with identified FLAIR late enhancing lesions and CASTING /MA30005 patients), 21. Other measures related to MS disease:Time to treatment discontinuation/switch, 22. Patient reported outcomes (PROs):Employment status (Work Productivity and Activity Impairment Questionnaire [WPAI]), 23. Patient reported outcomes (PROs):SymptoMScreen score, 24. Patient reported outcomes (PROs):Quality of life (Multiple Sclerosis Impact Scale [MSIS]-29), 25. Rate and nature of adverse events, 26. Changes in vital signs, neurological examinations, clinical laboratory results, locally reviewed MRI for safety (non-MS CNS pathology) and concomitant medications

Source: https://euclinicaltrials.eu/ctis-public/view/2023-506543-41-00